EU clinical trial 2023-508340-22-00: A PHASE 2 STUDY OF ALX148 IN COMBINATION WITH PEMBROLIZUMAB IN PATIENTS WITH ADVANCED HEAD AND NECK SQUAMOUS CELL CARCINOMA (ASPEN-03)
Protocol code: AT148003
Sponsor: Alx Oncology Inc. (Pharmaceutical company). Phase: Therapeutic exploratory (Phase II). Countries: Netherlands (ended), Belgium (ended), Spain (ended).
Therapeutic area(s): Diseases [C] - Neoplasms [C04]
Gender: Female, Male. Age: 18-64 years, 65+ years. Enrolment: 50.
Status: Ended. Start date (EU): 2021-08-11. End date (EU): 2026-04-22. Decision date: 2024-04-30. Results received: Yes. Last updated: 2026-03-30.
Decision dates by country: BE: 2024-05-06, NL: 2024-04-30, ES: 2024-04-30

Condition(s): metastatic or unresectable, recurrent HNSCC
Product: evorpacept, KEYTRUDA 25 mg/mL concentrate for solution for infusion

Primary endpoint: Objective response rate of ALX148 plus pembrolizumab (ORR; CR or PR using the Response Evaluation Criteria in Solid Tumors [RECIST] version 1.1).
Endpoint(s): Disease control rate (DCR), duration of response (DOR), time to tumor progression (TTP), Progression-free survival (PFS), and overall survival (OS), Adverse Events as characterized by type, frequency, severity (as graded by National Cancer Institute Common Terminology Criteria for Adverse Events (NCI CTCAE v. 5.0), timing, seriousness, and relationship to study therapy, Laboratory abnormalities as characterized by type, frequency, severity (as graded by NCI CTCAE v. 5.0) and timing, Pharmacokinetic parameters of ALX148 such as Cmax, Tmax, AUC, CL, and t1/2 as data permit, Immunogenicity; Human serum ADA (i.e., anti-ALX148 antibody) samples will be analyzed for the presence or absence of anti-ALX148 antibodies

Source: https://euclinicaltrials.eu/ctis-public/view/2023-508340-22-00